EU clinical trial 2023-508831-29-00: A Phase 2a, Open-label, Pilot Study to Evaluate Efficacy, Pharmacokinetics, Pharmacodynamics, Safety, and Tolerability of MYK-224 in Participants with Symptomatic Hypertrophic Cardiomyopathy and Left Ventricular Outflow Tract Obstruction (MERCUTIO)
Protocol code: CV029-009
Sponsor: Myokardia Inc. (Pharmaceutical company). Phase: Therapeutic exploratory (Phase II). Countries: Poland (ended), Italy (ended), Spain (ended).
Therapeutic area(s): Diseases [C] - Cardiovascular Diseases [C14]
Gender: Female, Male. Age: 18-64 years, 65+ years. Enrolment: 12.
Status: Ended. Start date (EU): 2023-02-15. End date (EU): 2025-02-27. End date: 2025-02-28. Decision date: 2024-03-20. Results received: Yes. Last updated: 2025-02-11.
Decision dates by country: IT: 2024-03-22, PL: 2024-03-25, ES: 2024-03-20

Condition(s): Symptomatic Hypertrophic Cardiomyopathy and Left Ventricular Outflow Tract Obstruction

Primary endpoint: Incidence, severity, and causality of AEs and SAEs, Incidence of symptomatic resting LVEF < 50% by TTE, Incidence of resting LVEF ≤ 30% by TTE, Incidence of MACE, including cardiovascular death, nonfatal stroke, nonfatal myocardial infarction, Incidence of hospitalizations (due to cardiovascular and noncardiovascular events), Incidence of HF events (including hospitalizations and urgent emergency room/outpatient visits for HF), Incidence of atrial fibrillation/flutter (new from screening and recurrent), Incidence of appropriate implantable cardioverter defibrillator therapy and resuscitated cardiac arrest, Incidence of ventricular tachyarrhythmias (includes ventricular XML File Identifier: 4aHMkMObTnpietQCrlOf/erzF34= Page 20/33 tachycardia, ventricular fibrillation, and Torsades de Pointes), Results of vital signs, physical exams, 12-lead ECG assessments (including HR), and clinical laboratory tests
Endpoint(s): Effect on LVOT gradient, PK/PD relationship, PK concentrations

Source: https://euclinicaltrials.eu/ctis-public/view/2023-508831-29-00